EU clinical trial 2024-512949-17-00: A Randomized, Double-Blind, Placebo Controlled, Cross-Over Study to Evaluate the Efficacy, Safety and Tolerability of Daily Oral SCI-110 in Treating Adults with Tourette Syndrome
Protocol code: SCI-021-001
Sponsor: Neurothera Labs Inc. (Pharmaceutical company). Phase: Therapeutic exploratory (Phase II). Countries: Germany (authorised, recruiting).
Therapeutic area(s): Diseases [C] - Nervous System Diseases [C10]
Gender: Female, Male. Age: 18-64 years, 65+ years. Enrolment: 56.
Status: Authorised, recruiting. Start date (EU): 2026-03-26. Decision date: 2024-07-05. Results received: No. Last updated: 2026-04-23.

Condition(s): Tourette's syndrome in adults (≥18 and ≤65 years) in out-patient care
Product: SCI-110 Placebo Drug Product, SCI-110_DF1, SCI-110_DF2, SCI-110_DF3

Primary endpoint: [CCI]
Endpoint(s): [CCI], [CCI], [CCI], [CCI], [CCI], [CCI], [CCI], Number of adverse events (AEs), number and rate of patients affected by AEs, SAEs, SUSARs/ADRs, AESIs and AEs leading to withdrawal at each visit., Absolute values of vital signs (blood pressure, heart rate) at each visit and change from baseline for each visit. Number and percentage of clinically significant abnormal values.

Source: https://euclinicaltrials.eu/ctis-public/view/2024-512949-17-00